EU clinical trial 2023-503576-25-00: A Phase 3, Randomized, Double-Blind, Placebo-Controlled Study to Evaluate the Efficacy and Safety of Pegozafermin in Subjects with Severe Hypertriglyceridemia (SHTG)
Protocol code: BIO89-100-231
Sponsor: 89bio Inc. (Pharmaceutical company). Phase: Therapeutic confirmatory (Phase III). Countries: Spain (ended), Poland (ended), Hungary (ended), Latvia (ended), Austria (ended), Bulgaria (ended), Belgium (ended), Czechia (ended), Italy (ended), Germany (ended), France (ended).
Therapeutic area(s): Diseases [C] - Nutritional and Metabolic Diseases [C18]
Gender: Female, Male. Age: 18-64 years, 65+ years. Enrolment: 169.
Status: Ended. Start date (EU): 2023-09-22. End date (EU): 2026-02-13. Decision date: 2023-08-23. Results received: No. Last updated: 2026-04-24.
Decision dates by country: BE: 2023-11-29, IT: 2023-11-20, FR: 2023-11-30, PL: 2023-08-28, DE: 2023-11-29, AT: 2023-08-28, HU: 2023-08-28, LV: 2023-08-25, BG: 2023-08-28, CZ: 2023-11-29, ES: 2023-08-23

Condition(s): Severe Hypertriglyceridemia
Product: Placebo for pegozafermin. combined integral administration device: pre-filled syringe - please refer to the impd pegozafermin section 3.2.p.7 container closure system for detailed description., SIMVASTATINA DOC 10 mg compresse rivestite con film, Pegozafermin

Primary endpoint: Percent change from baseline in fasting TG at Week 26
Endpoint(s): 1. Percent change from baseline in non-high-density lipoprotein cholesterol (non-HDL-C) at Week 26, 2. Percent change from baseline in high-density lipoprotein cholesterol (HDL-C) at Week 26, 3. Percent change from baseline in very low-density lipoprotein cholesterol (VLDL-C) at Week 26, 4. Percent change from baseline in total cholesterol (TC) at Week 26, 5. Percent change from baseline in fasting TG at Week 52, 6. Change from baseline in liver fat by magnetic resonance imaging - whole liver proton density fat fraction (MRI-PDFF) at Week 26, 7. Percent change from baseline in apolipoprotein B (apo-B) at Week 26, 8. Change in HbA1c at Week 26 for those with baseline ≥7.0%

Source: https://euclinicaltrials.eu/ctis-public/view/2023-503576-25-00